EU clinical trial 2024-514764-72-00: A Phase 3, Randomized, Double-Blind, Parallel Group, Multicentre Study to Compare Efficacy, Safety, Pharmacodynamics, Pharmacokinetics, immunogenicity, of BP11 versus EU-Approved Xolair in patients With Chronic Spontaneous Urticaria Who Are Resistant to H1 Antagonist.
Protocol code: BP11-301
Sponsor: Curateq Biologics Private Limited (Pharmaceutical company). Phase: Therapeutic confirmatory (Phase III). Countries: Hungary (ended), Latvia (ended), Bulgaria (ended), Slovakia (ended), Poland (ended), Lithuania (ended).
Therapeutic area(s): Diseases [C] - Skin and Connective Tissue Diseases [C17]
Gender: Female, Male. Age: 18-64 years, 65+ years. Enrolment: 474.
Status: Ended. Start date (EU): 2023-09-27. End date (EU): 2026-03-10. End date: 2026-03-11. Decision date: 2024-08-27. Results received: No. Last updated: 2026-05-22.
Decision dates by country: LT: 2024-09-13, LV: 2024-08-27, BG: 2024-09-16, HU: 2024-08-27, SK: 2024-08-28, PL: 2024-09-23

Condition(s): Chronic Urticaria
Product: Xolair 150 mg solution for injection in pre-filled syringe, Placebo, solution for injection in pre-filled syringe, BP11

Primary endpoint: Change from Baseline in weekly Itch Severity Score (ISS7) at Week 12
Endpoint(s): Change from Baseline in ISS7 at Weeks 2, 4, 8, 16, 20, and 24, Change from Baseline in weekly Urticaria Activity Score (UAS7) at Weeks 2, 4, 8, 12, 16, 20, and 24, Percentage of patients with UAS7 of ≤6 at Weeks 2, 4, 8, 12, 16, 20, and 24, Percentage of complete responders (UAS7 = 0) in UAS7 at Weeks 2, 4, 8, 12, 16, 20, and 24, Change from Baseline in weekly Hives Severity Score (HSS7) at Weeks 2, 4, 8, 12, 16, 20, and 24, Change from Baseline in the overall Dermatology Life Quality Index (DLQI) score at Weeks 4, 8, 12, 16, 20, and 24, Use of rescue medication up to scheduled efficacy time points and over the study (at Weeks 2, 4, 8, and 12, and by treatment period), Incidence, nature, and severity of adverse events (AEs) including adverse drug reactions graded according to the National Cancer Institute's Common Terminology Criteria for Adverse Events (NCI CTCAE) v5.0 as defined by treatment-emergent AEs (TEAEs), serious AEs (SAEs), AEs of special interest (AESIs), related TEAEs, and related SAEs during Treatment Period 1 (TP1) and Treatment Period 2 (TP2), Injection-site and hypersensitivity reactions at Baseline (Week 0 after first study drug dose) and at Weeks 4, 8, 12, 16, and 20, and throughout the study, Physical examinations, vital signs, and 12-lead electrocardiograms (ECGs) throughout the study, Laboratory parameters (hematology, serum chemistry, and urinalysis) throughout the study, Incidence of antidrug antibodies (ADAs) and neutralizing antibodies (NAbs) and ADA titers to omalizumab measured during TP1 at Baseline (Week 0) and at Weeks 4 and 12, Incidence of ADAs and NAbs and ADA titers to omalizumab measured during TP2 at Weeks 20, 24, and 40, Trough serum concentration (Ctrough) of omalizumab during TP1 at Baseline and at Weeks 4 and 12, Trough serum concentration (Ctrough) of omalizumab during TP2 at Weeks 20, 24, and 40, Total IgE and free IgE levels in serum during TP1 at Baseline (Week 0) and at Weeks 4 and 12, Total IgE and free IgE levels in serum during TP2 at Weeks 20, 24, and 40, Incidence, nature, and severity of AEs including adverse drug reactions graded according to the NCI CTCAE v5.0 as defined by TEAEs, SAEs, AESIs, related TEAEs, and related SAEs during TP2 for patients who switch treatment, Injection-site and hypersensitivity reactions during TP2 for patients who switch treatment, Physical examinations, vital signs, and 12-lead ECGs during TP2 for patients who switch treatment, Laboratory parameters (hematology, clinical chemistry, and urinalysis) during TP2 for patients who switch treatment, Incidence of ADAs and NAbs and ADA titers to omalizumab measured during TP2 for patients who switch treatment

Source: https://euclinicaltrials.eu/ctis-public/view/2024-514764-72-00